EU clinical trial 2023-504539-42-00: A Randomized, Double-Blind, Placebo-Controlled, Phase 2 Study to Evaluate the Efficacy, Safety, and Tolerability of Abrocitinib in Subjects with Moderate to Severe Chronic Hand Eczema Refractory to Corticosteroid Therapy
Protocol code: INNO-6052
Sponsor: Innovaderm Research Inc. (Pharmaceutical company). Phase: Therapeutic exploratory (Phase II). Countries: Poland (ended).
Therapeutic area(s): Diseases [C] - Skin and Connective Tissue Diseases [C17]
Gender: Female, Male. Age: 18-64 years, 65+ years. Enrolment: 70.
Status: Ended. Start date (EU): 2024-10-20. End date (EU): 2025-11-03. End date: 2025-11-04. Decision date: 2024-06-10. Results received: No. Last updated: 2025-11-12.

Condition(s): Moderate to severe chronic hand eczema
Product: Cibinqo 100 mg film-coated tablets, Placebo

Primary endpoint: Percent change from baseline in hand mTLSS at Week 16
Endpoint(s): Percent change from baseline in hand mTLSS at Weeks 2, 4, and 12, Proportion of subjects achieving at least a 2-grade reduction from baseline to clear (0) or almost clear (1) in hand PGA at Weeks 2, 4, 12, and 16, Proportion of subjects achieving at least a 2-grade reduction from baseline in hand PGA at Weeks 2, 4, 12, and 16, Percent change from baseline in HESCI at Weeks 2, 4, 12, and 16, Percent change from baseline in Extent of Disease affected with moderate to severe CHE at Weeks 2, 4, 12 and 16., Actual PaGA measeruments at Weeks 2, 4, 12 and 16, Percent change from baseline in hand DLQI at Weeks 2, 4, 12 and 16, Percent change from baseline in QOLHEQ at Weeks 2, 4, 12 and 16, Percent change from baseline in pain NRS at Weeks 2, 4, 12 and 16, Percent change from baseline in itch NRS at Weeks 2, 4, 12 and 16, Number of TEAEs, Number of treatment-related TEAEs, Vital signs and safety laboratory tests

Source: https://euclinicaltrials.eu/ctis-public/view/2023-504539-42-00